EU clinical trial 2023-509444-10-00: A Phase 1/2 Open-Label, Ascending Dose, Multicentre Study to Evaluate the Safety and Preliminary Efficacy of AVB-101 Administered by Bilateral Intrathalamic Infusion in Subjects With Frontotemporal Dementia With Progranulin Mutations (FTD-GRN)
Protocol code: AVB-PGRN-001
Sponsor: Aviadobio Limited (Pharmaceutical company). Phase: Phase I and Phase II (Integrated)- First administration to humans. Countries: Sweden (authorised, recruitment pending), Spain (ongoing, recruiting), Belgium (ongoing, recruiting), Netherlands (authorised, recruitment pending), Italy (ongoing, recruiting), Poland (ongoing, recruiting).
Therapeutic area(s): Diseases [C] - Nervous System Diseases [C10]
Gender: Female, Male. Age: 18-64 years, 65+ years. Enrolment: 16.
Start date (EU): 2024-02-08. Decision date: 2024-04-22. Results received: No. Last updated: 2026-03-09.
Decision dates by country: BE: 2024-04-25, PL: 2024-05-16, IT: 2024-05-13, ES: 2024-04-24, NL: 2024-04-22, SE: 2024-04-22

Condition(s): Frontotemporal Dementia With Progranulin Mutations (FTD-GRN)
Product: AVB-101

Primary endpoint: 1.1. Over a 26-week initial and 5-year total follow-up period: - Number and incidence of AEs, SAEs, and clinically meaningful laboratory test abnormalities;, 1.2. Over a 26-week initial and 5-year total follow-up period: - Change from baseline in vital signs, ECG parameters, and physical and neurological examinations, 1.3. Over a 26-week initial and 5-year total follow-up period: - Change from baseline in the MMSE;, 1.4. Over a 26-week initial and 5-year total follow-up period: - Change from baseline in biochemistry and hematology safety laboratory tests, 1.5. Over a 26-week initial and 5-year total follow-up period: - Incidence of treatment-emergent suicidal ideation or behavior as measured on the C-SSRS;, 1.6. Over a 26-week initial and 5-year total follow-up period: - Change from baseline in MRI results including edema, inflammation, asymptomatic/symptomatic hemorrhage, and other structural changes.
Endpoint(s): 1.1. Over a 26-week initial and 5-year total follow-up period: - Change from baseline in PGRN protein levels in CSF and blood., 1.2. Over a 5-year follow-up period: - Change from baseline in CDR + NACC FTLD-SB score; and - Change in CGI-C, PGI-C, and CaGI-C

Source: https://euclinicaltrials.eu/ctis-public/view/2023-509444-10-00